EU clinical trial 2023-505546-26-00: SAD and MAD of VENT-02 in healthy volunteers
Sponsor: Ventus Therapeutics U.S. Inc. (Pharmaceutical company). Phase: Human Pharmacology (Phase I)- First administration to humans. Countries: Netherlands (ended).
Therapeutic area(s): Diseases [C] - Nervous System Diseases [C10]
Gender: Female, Male. Age: 18-64 years, 65+ years. Enrolment: 86.
Status: Ended. Start date (EU): 2023-07-21. End date (EU): 2024-04-17. Decision date: 2023-07-20. Results received: No. Last updated: 2024-03-13.

Condition(s): Neuroinflammatory and neurodegenerative diseases

Source: https://euclinicaltrials.eu/ctis-public/view/2023-505546-26-00